EU clinical trial 2024-511363-28-00: A phase 3, randomized, double-blind, placebo-controlled, multicenter study to evaluate the efficacy and safety of subcutaneous sonelokimab in adult participants with moderate to severe hidradenitis suppurativa (M1095-HS-302)
Protocol code: M1095-HS-302
Sponsor: MoonLake Immunotherapeutics AG (Pharmaceutical company). Phase: Therapeutic confirmatory (Phase III). Countries: Netherlands (ended), Slovakia (ended), Czechia (ended), France (ended), Bulgaria (ended), Spain (ended), Poland (ended), Ireland (ended), Belgium (ended), Germany (ended).
Therapeutic area(s): Diseases [C] - Immune System Diseases [C20]; Diseases [C] - Skin and Connective Tissue Diseases [C17]
Gender: Female, Male. Age: 18-64 years, 65+ years. Enrolment: 292.
Status: Ended. Start date (EU): 2024-09-24. End date (EU): 2026-05-20. End date: 2026-05-21. Decision date: 2024-09-02. Results received: No. Last updated: 2026-05-28.
Decision dates by country: BE: 2024-09-02, CZ: 2024-09-03, FR: 2024-09-03, IE: 2024-09-04, NL: 2024-09-02, PL: 2024-09-04, SK: 2024-09-02, BG: 2024-09-03, ES: 2024-09-04, DE: 2024-09-04

Condition(s): hidradenitis suppurativa (HS)
Product: Placebo is a sterile solution in a single use prefilled syringe (PFS) intended for subcutaneous administration, Sonelokimab

Primary endpoint: Percentage of participants achieving HiSCR75 at Week 16
Endpoint(s): Treatment-emergent adverse event (TEAEs), Serious adverse event (SAEs), TEAEs leading to study withdrawal, Adverse event of special interest (AESIs), Physical examinations, vital signs, and ECG results, Abnormal laboratory parameters (hematology, clinical chemistry, urinalysis), 1. Percentage of participants achieving HiSCR50 at Week 16, 2. Percentage of participants achieving IHS4-55 at Week 16, 5. Percentage of participants achieving a DLQI total reduction of ≥4 (minimal clinically important difference) at Week 16 among participants with a baseline DLQI ≥4, 3. Percentage of participants achieving a ≥3-unit reduction at Week 16 in the NRS for skin pain in PGA among participants with a baseline NRS ≥3, 4. Absolute change in HiSQOL score at Week 16

Source: https://euclinicaltrials.eu/ctis-public/view/2024-511363-28-00